EU clinical trial 2022-502956-29-00: An International, Prospective, Open-label, Multi-center, Randomized Phase III Study comparing lutetium (177Lu) vipivotide tetraxetan (AAA617) versus Observation to delay castration or disease recurrence in adult male patients with prostate-specific membrane antigen (PSMA) positive Oligometastatic Prostate Cancer (OMPC)
Protocol code: CAAA617D12302
Sponsor: Novartis Pharma AG (Pharmaceutical company). Phase: Therapeutic confirmatory (Phase III). Countries: France (ongoing, recruiting), Czechia (ongoing, recruiting), Spain (ongoing, recruiting), Belgium (ongoing, recruiting), Italy (ongoing, recruiting), Slovakia (ongoing, recruiting), Germany (ongoing, recruiting), Hungary (ongoing, recruiting), Austria (ongoing, recruiting), Greece (ongoing, recruiting), Netherlands (ongoing, recruiting).
Therapeutic area(s): Diseases [C] - Neoplasms [C04]
Gender: Male. Age: 18-64 years, 65+ years. Enrolment: 215.
Status: Ongoing, recruiting. Start date (EU): 2024-07-01. Decision date: 2023-11-14. Results received: No. Last updated: 2026-05-07.
Decision dates by country: BE: 2023-11-14, IT: 2023-11-20, SK: 2023-11-14, CZ: 2023-11-14, HU: 2023-11-20, AT: 2023-11-20, ES: 2023-11-20, GR: 2025-01-28, FR: 2023-11-17, NL: 2025-02-03, DE: 2023-11-16

Condition(s): Oligometastatic prostate cancer (OMPC)
Product: Locametz 25 micrograms kit for radiopharmaceutical preparation, PIFLUFOLASTAT (18F), PIFLUFOLASTAT (18F), Pluvicto 1 000 MBq/mL solution for injection/infusion

Primary endpoint: MFS is defined as the time from randomization to the first evidence of radiographically detectable bone or soft tissue distant metastasis by CI (i.e., CT/MRI and bone scans) as assessed by BIRC using RECIST 1.1 or death from any cause, whichever occurs first
Endpoint(s): TTHT is defined as the time from randomization to the time to ADT for castration. The type of hormonal therapy will be at the discretion of the Investigator, Investigator assessed MFS is defined as the time from randomization to the first evidence of radiographically detectable bone or soft tissue distant metastasis by CI (i.e., CT/MRI and bone scans) as assessed by Investigator using RECIST 1.1 or death from any cause, whichever occurs first, Time to PSA progression is defined as time from randomization to first PSA progression 1. PSA progression 1 is defined as a rising PSA confirmed on repeated measurement at least 3 weeks later, and at least greater than 25% and ≥2 ng/mL above nadir or baseline, whichever is lower, rPFS is defined as the time from randomization to first documentation of confirmed radiographic progressive disease by CI(i.e., CT/MRI and bone scans) using RECIST 1.1 or death due to any cause (whichever occurs first), Time to next therapy is defined as time from randomization to initiation of the next line of therapy (local or systemic), 24-month PSA PFS (≥ 0.5 ng/mL) is defined as PSA PFS at 24 months. PSA PFS is defined as the time from date of randomization to the date of first documented PSA progression 2 or death from any cause, whichever occurs first. PSA progression 2 is defined as a PSA concentration above the nadir (or baseline if lower) of ≥ 0.5 ng/mL, confirmed by repeated measurement at least 3 weeks later, Time to symptomatic progression is defined as time from randomization to the date of first documented event for any of the following, whichever occurs first. • Development of a symptomatic skeletal event (SSE), • Escalation in cancer-related pain or worsening of disease-related symptoms leading to the initiation of a new systemic anticancer therapy • Development of clinically significant symptoms due to local or regional tumor progression leading to surgery or radiation therapy, HRQoL as assessed by FACT-P, BPI-SF, FACT-RNT and EQ-5D-5L, Time to SSE (TTSSE) is defined as date of randomization to the date of first new symptomatic pathological bone fracture, spinal cord compression, tumor-related orthopedic surgical intervention, requirement for radiation therapy to relieve bone pain or death from any cause, whichever occurs first, Safety: incidence and severity of AEs and serious adverse event (SAEs), changes in laboratory values, vital signs and ECGs. Any clinically significant lab, vital signs, ECG abnormalities will be captured as an AE. Tolerability: dose interruptions, reductions and dose intensity, OS is defined as the time from the date of randomization to the date of death due to any cause

Source: https://euclinicaltrials.eu/ctis-public/view/2022-502956-29-00